EU clinical trial 2022-502313-28-00: A multicenter randomized, double-blind, placebo-controlled Phase 2 study to evaluate efficacy, safety, tolerability, pharmacokinetics and target engagement of GSK3858279 in adult participants with chronic Diabetic Peripheral Neuropathic Pain (DPNP) / NEPTUNE-17.
Protocol code: 214221
Sponsor: Glaxosmithkline Research & Development Limited (Pharmaceutical company). Phase: Therapeutic exploratory (Phase II). Countries: Spain (ended), Germany (ended), France (ended), Poland (ended).
Therapeutic area(s): Diseases [C] - Nervous System Diseases [C10]
Gender: Female, Male. Age: 18-64 years, 65+ years. Enrolment: 80.
Status: Ended. Start date (EU): 2023-12-14. End date (EU): 2024-10-03. End date: 2025-02-17. Decision date: 2023-07-25. Results received: Yes. Last updated: 2024-11-04.
Decision dates by country: DE: 2023-07-25, ES: 2023-07-25, PL: 2023-07-31, FR: 2023-07-31

Condition(s): Diabetic Peripheral Neuropathic Pain
Product: Sterile 0.9% (w/v) Sodium Chloride

Primary endpoint: Change from baseline in the weekly average of average daily pain intensity at Week 12, assessed on the Numeric Rating Scale (NRS)

Source: https://euclinicaltrials.eu/ctis-public/view/2022-502313-28-00